EU clinical trial 2023-504855-28-00: A Phase 1, Open-label, Multicenter Study of the Safety, Pharmacokinetics, and Pharmacodynamics of MK-4464 as Monotherapy and in Combination with Pembrolizumab in Participants with Advanced/Metastatic Solid Tumors
Protocol code: MK-4464-001
Sponsor: Merck Sharp & Dohme LLC (Pharmaceutical company). Phase: Human Pharmacology (Phase I)- First administration to humans. Countries: Netherlands (ended).
Therapeutic area(s): Diseases [C] - Neoplasms [C04]
Gender: Female, Male. Age: 18-64 years, 65+ years. Enrolment: 30.
Status: Ended. Start date (EU): 2023-03-21. End date (EU): 2025-04-10. End date: 2025-09-18. Decision date: 2023-06-21. Results received: No. Last updated: 2025-02-20.

Condition(s): advanced/metastatic solid tumors

Source: https://euclinicaltrials.eu/ctis-public/view/2023-504855-28-00